EU clinical trial 2024-519913-76-00: An open-label randomised, phase II trial of Datopotamab deruxtecan plus Durvalumab versus Datopotamab deruxtecan in patients with PDL1-negative metastatic triple-negative breast cancer
Protocol code: 1011098
Sponsor: Queen Mary University Of London (Educational Institution). Phase: Therapeutic exploratory (Phase II). Countries: Spain (ongoing, recruiting), Germany (ongoing, recruiting).
Therapeutic area(s): Diseases [C] - Neoplasms [C04]
Gender: Female. Age: 18-64 years. Enrolment: 80.
Status: Ongoing, recruiting. Start date (EU): 2025-12-09. Decision date: 2025-10-23. Results received: No. Last updated: 2026-05-18.
Decision dates by country: DE: 2025-10-24, ES: 2025-10-23

Condition(s): PDL1-negative metastatic triple-negative breast cancer
Product: Datopotamab deruxtecan, DURVALUMAB

Primary endpoint: PFS is defined as the time from the date of randomisation to the date of first documented confirmed tumour progression (using RECIST 1.1) or death from any cause, whichever occurs first in all patients.
Endpoint(s): OS is defined as the time from date of randomisation to the date of death due to any cause in all patients, ORR is defined as the proportion of the patients in the analysis population who have a complete response (CR) or partial response (PR) (using RECIST 1.1)., DoR is defined as the time from first documentation of CR or PR to confirmed disease progression using RECIST 1.1, or death on study from any cause, whichever occurs first, in patients with objective response., CBR is defined as the percentage of patients who have achieved at least one CR or PR or met the SD criteria at least once after randomisation for a minimum interval of 24 weeks (using RECIST 1.1)., DoCB is calculated as time (in months) from randomisation to progression or death from any cause in patients with a clinical benefit., Changes in quality of life measured by the time to deterioration (TTD) in Items 29 (overall health) and 30 (overall QoL) of the EORTC Quality of Life Questionnaire Core 30 (QLQ-C30) and the percentages of patients with a decrease or increase of ≥ 10 points on the global health status/HRQoL scale of the EORTC QLQ-C30 and on subsets, respectively., Incidence, nature and severity of adverse events with severity determined according to CTCAE v5.0.

Source: https://euclinicaltrials.eu/ctis-public/view/2024-519913-76-00